EU clinical trial 2025-522776-93-00: A FIRST-IN-HUMAN (FIH) PHASE 1/2 STUDY TO ASSESS SAFETY, TOLERABILITY, AND PRELIMINARY ANTI-TUMOR ACTIVITY OF REGN17372, AN ANTI-GPRC5D X ANTI-CD28 COSTIMULATORY BISPECIFIC MONOCLONAL ANTIBODY, IN COMBINATION WITH LINVOSELTAMAB, AN ANTI-BCMA X ANTI-CD3 BISPECIFIC MONOCLONAL ANTIBODY, IN PARTICIPANTS WITH RELAPSED/REFRACTORY MULTIPLE MYELOMA
Protocol code: R17372-HM-2493
Sponsor: Regeneron Pharmaceuticals Inc. (Pharmaceutical company). Phase: Human Pharmacology (Phase I)- First administration to humans. Countries: Greece (authorised, recruitment pending).
Therapeutic area(s): Diseases [C] - Neoplasms [C04]
Gender: Female, Male. Age: 18-64 years, 65+ years. Enrolment: 26.
Status: Authorised, recruitment pending. Decision date: 2026-04-22. Results received: No. Last updated: 2026-07-02.

Condition(s): Relapsed/Refractory Multiple Myeloma
Product: Paracetamol 1000mg Tablets, LYNOZYFIC 200 mg concentrate for solution for infusion, LYNOZYFIC 5 mg concentrate for solution for infusion, REGN17372, Diphenhydramine Hydrochloride Tablets 25 mg, Diphenhydramin-Hevert Injektionslösung, Dexamethasone 3.3 mg/ml solution for injection/infusion

Primary endpoint: Phase 1: Occurrence of Dose Limiting Toxicities (DLTs) from the first dose of REGN17372 in combination with linvoseltamab, Phase 1: Occurrence of Treatment Emergent Adverse Events (TEAEs) associated with REGN17372 in combination with linvoseltamab, Phase 1: Severity of TEAEs associated with REGN17372 in combination with linvoseltamab, Phase 2: Very Good Partial Response (VGPR) or better as determined by the investigator using the International Myeloma Working Group (IMWG) response criteria in patients receiving combination study drugs, Phase 2: VGPR or better as determined by the investigator using the IMWG response criteria in patients receiving Linvoseltamab monotherapy, Phase 2: Partial Response (PR) or better as determined by the investigator using the IMWG response criteria in patients receiving combination study drugs, Phase 2: PR or better as determined by the investigator using the IMWG response criteria in patients receiving Linvoseltamab monotherapy
Endpoint(s): Phase 1 and Phase 2: Concentrations of REGN17372 in serum, Phase 1 and Phase 2: Concentrations of linvoseltamab in serum, Phase 1 and Phase 2: Occurrence of Anti-Drug Antibodies (ADA) to REGN17372, Phase 1 and Phase 2: Magnitude of ADA to REGN17372, Phase 1 and Phase 2: Incidence of ADA to linvoseltamab, Phase 1 and Phase 2: Magnitude of ADA to linvoseltamab, Phase 1 and Phase 2: Objective Response Rate (ORR) as assessed by IMWG response criteria as determined by the investigator, Phase 1 and Phase 2: Complete response (CR) as assessed by IMWG response criteria as determined by the investigator, Phase 1 and Phase 2: VGPR as assessed by IMWG response criteria, as determined by the investigator, Phase 1 and Phase 2: Duration of Response (DOR) as assessed by IMWG criteria as determined by the investigator, Phase 1 and Phase 2: Progression Free Survival (PFS) as assessed by IMWG criteria as determined by the investigator, Phase 1 and Phase 2: Minimal Residual Disease (MRD) negative status (at 10^-5) in participants in CR or better, Phase 1 and Phase 2: Overall Survival (OS), Phase 1: ORR as assessed using the IMWG response criteria as determined by the investigator in patients receiving combination study drugs, Phase 1:VGPR assessed using IMWG criteria as determined by the investigator in patients receiving combination study drugs, Phase 2: Incidence of TEAEs, Phase 2: Severity of TEAEs, Phase 2: Change from baseline in European Organization for Research and Treatment of Cancer Quality of Life Core Questionnaire (EORTC QLQ-C30) Global Health Status / Quality of Life (GHS/QoL), Phase 2: Change from baseline in EORTC QLQ-C30 Physical Functioning (PF), Phase 2: Change from baseline in EORTC QLQ-C30 Role Functioning (RF), Phase 2: Change from baseline in EORTC QLQ-C30 pain, Phase 2: Change from baseline in EORTC QLQ-C30 fatigue, Phase 2: Time to definitive deterioration in EORTC QLQ-C30 GHS/QoL, Phase 2: Time to definitive deterioration in EORTC QLQ-C30 PF, Phase 2: Time to definitive deterioration in EORTC QLQ-C30 RF, Phase 2: Time to definitive deterioration in EORTC QLQ-C30 pain, Phase 2: Time to definitive deterioration in EORTC QLQ-C30 fatigue, Phase 2: Time to first improvement in EORTC QLQ-C30 GHS/QoL, Phase 2: Time to first improvement in EORTC QLQ-C30 PF, Phase 2: Time to first improvement in EORTC QLQ-C30 RF, Phase 2: Time to first improvement in EORTC QLQ-C30 pain, Phase 2: Time to first improvement in EORTC QLQ-C30 fatigue, Phase 2: Change from baseline in EORTC QLQ-Multiple Myeloma Module (MY20) Disease Symptoms (DS), Phase 2: Time to definitive deterioration in EORTC QLQ-MY20 DS, Phase 2: Time to first improvement in EORTC QLQ-MY20 DS, Phase 2: Change from baseline in EORTC QLQ-MY20 Treatment Side Effects (TSE), Phase 2: Time to definitive deterioration in EORTC QLQ-MY20 TSE, Phase 2: Time to first improvement in EORTC QLQ-MY20 TSE, Phase 2: Change from baseline in EuroQoL-5 Dimensions, 5-level Questionnaire (EQ-5D-5L) Visual Analogue Score (VAS) (EQ-5D-5L VAS), Phase 2: Time to definitive deterioration in EQ-5D-5L VAS, Phase 2: Time to first improvement in EQ-5D-5L VAS, Phase 2: Patient-reported overall impact of treatment toxicity measured by Functional Assessment of Cancer Therapy (FACIT) Item GP5, Phase 2: Patient-reported tolerability as measured by the Patient Reported Outcome-Common Terminology Criteria for Adverse Events (PRO-CTCAE)

Source: https://euclinicaltrials.eu/ctis-public/view/2025-522776-93-00